EU clinical trial 2023-505690-33-00: A Phase 1b Multicentre, Open-label, Modular, Dose-finding and Dose-expansion Study to Explore the Safety, Tolerability, Pharmacokinetics and Anti-tumour Activity of Trastuzumab Deruxtecan (T-DXd) in Combination with Other Anti-cancer Agents in Patients with Metastatic HER2-low Breast Cancer (DESTINY-Breast08)
Protocol code: D967JC00002
Sponsor: Astrazeneca AB (Pharmaceutical company). Phase: Human Pharmacology (Phase I)- Other. Countries: Belgium (ended).
Therapeutic area(s): Diseases [C] - Neoplasms [C04]
Gender: Female, Male. Age: 18-64 years, 65+ years. Enrolment: 12.
Status: Ended. Start date (EU): 2022-03-11. End date (EU): 2026-03-12. Decision date: 2024-07-24. Results received: No. Last updated: 2026-01-21.

Condition(s): Metastatic Breast Cancer
Product: TRUQAP 200 mg film-coated tablets, Faslodex 250 mg solution for injection., TRUQAP 160 mg film-coated tablets, PACLITAXEL, IMFINZI 50 mg/mL concentrate for solution for infusion., Capecitabine Accord 500 mg film-coated tablets, Capecitabine Accord 150 mg film-coated tablets, DS-8201a, Arimidex® 1 mg film-coated tablets

Primary endpoint: Part 1: AEs, SAEs, DLTs, laboratory findings, Part 2: AEs, SAEs, laboratory findings
Endpoint(s): Part 2: ORR defined as the proportion of patients who have a confirmed CR or PR, as determined by the investigator at local site per RECIST 1.1, Part 2: PFS defined as time from the date of first dose until the date of progression as determined by the investigator at local site per RECIST 1.1, or death due to any cause, Part 2: DoR defined as time from the date of first documented response (which is subsequently confirmed) until the date of documented progression or death in the absence of disease progression, Part 2: OS defined as time from the date of first dose until the date of death by any cause, Serum concentration of T-DXd, total anti-HER2 antibody and MAAA- 1181a, Serum concentration of durvalumab, Immunogenicity of T-DXd and durvalumab

Source: https://euclinicaltrials.eu/ctis-public/view/2023-505690-33-00